EU clinical trial 2022-502225-17-00: HOVON 164 HL: Tislelizumab plus Gemcitabine and Cisplatin for Relapsed or Refractory Hodgkin Lymphoma followed by Tislelizumab Consolidation in Patients in Metabolic Complete Remission (TIGERR-HL). An open label phase II trial.
Protocol code: HO164
Sponsor: Hemato-Oncologie voor Volwassenen Nederland (Hovon) Stichting (Patient organisation/association). Phase: Therapeutic exploratory (Phase II). Countries: Netherlands (ongoing, recruitment ended), Denmark (ongoing, recruitment ended), Belgium (ongoing, recruitment ended).
Therapeutic area(s): Diseases [C] - Hemic and Lymphatic Diseases [C15]
Gender: Female, Male. Age: 18-64 years, 65+ years. Enrolment: 75.
Status: Ongoing, recruitment ended. Start date (EU): 2023-07-14. Decision date: 2023-04-14. Results received: No. Last updated: 2026-05-06.
Decision dates by country: DK: 2023-04-18, BE: 2023-04-19, NL: 2023-04-14

Condition(s): Hodgkin lymphoma
Product: PEGFILGRASTIM, CISPLATIN, Tislelizumab, GEMCITABINE

Primary endpoint: Progression free survival probability at 2 years. PFS is defined as time from registration to progression or death from any cause, whichever comes first.
Endpoint(s): ORR, mCR and mPR rates (as assessed by FDG-PET/CT) after 2 and 4 cycles of tislelizumab in combination with GP chemotherapy induction., Rate of CTCAE grade 3/4 toxicities of tislelizumab in combination with GP chemotherapy., Rate of CTCAE grade 2 to 4 immune related toxicities of tislelizumab in combination with GP chemotherapy., Rate of CTCAE grade 3/4 toxicities of tislelizumab consolidation treatment., PFS as time-to-event outcome., EFS defined as time from registration to start new HL treatment, progression or death from any cause, whichever comes first., DFS defined as time from start of consolidation therapy to relapse or death from any cause, whichever comes first., OS defined as time from registration to death from any cause.

Source: https://euclinicaltrials.eu/ctis-public/view/2022-502225-17-00